EU clinical trial 2022-502366-25-00: A three-year, multi-center, double-blind, extension study to evaluate the long-term safety and efficacy of ligelizumab in patients who completed ligelizumab’s Phase III studies in food allergy
Protocol code: CQGE031G12303B
Sponsor: Novartis Pharma AG (Pharmaceutical company). Phase: Therapeutic confirmatory (Phase III). Countries: Netherlands (ended), France (ended), Spain (ended), Italy (ended), Germany (ended).
Therapeutic area(s): Diseases [C] - Immune System Diseases [C20]
Gender: Female, Male. Age: 0-17 years, 18-64 years. Enrolment: 55.
Status: Ended. Start date (EU): 2023-09-11. End date (EU): 2025-02-14. End date: 2025-03-06. Decision date: 2023-08-21. Results received: Yes. Last updated: 2024-06-14.
Decision dates by country: DE: 2023-08-23, IT: 2023-08-23, ES: 2023-08-23, NL: 2023-08-22, FR: 2023-08-21

Condition(s): Food allergy
Product: SALBUTAMOL, PCM001, EPINEPHRINE, placebo to QGE031 120 mg/ mL solution for injection in pre-filled syringe, EPINEPHRINE, QGE031, SALBUTAMOL, PCM001

Primary endpoint: Overall incidence and exposure-adjusted occurrence rates of treatment-emergent AEs and SAEs
Endpoint(s): Proportion of participants tolerating a single dose of ≥ 600 mg of peanut protein without dose limiting symptoms during an open label OFC at scheduled timepoints, Overall incidence and exposure-adjusted occurrence rates of treatment-emergent AEs and SAEs, Summaries of total scores in the FAQLQ, FAIM and SF-36v2 by age and responder (participants and/or caregiver) at scheduled timepoints

Source: https://euclinicaltrials.eu/ctis-public/view/2022-502366-25-00